EU clinical trial 2025-522191-86-00: A multicentre, randomised, double-blind, parallel group, placebo-controlled trial to assess the effects of oral TRPC6 inhibitor BI 764198 taken over a 104 week treatment period in adult and adolescent participants with primary focal segmental glomerulosclerosis (pFSGS) or genetic FSGS related to TRPC6 gene variants
Protocol code: 1434-0017
Sponsor: Boehringer Ingelheim International GmbH, Boehringer Ingelheim Espana S.A. (Pharmaceutical company). Phase: Therapeutic confirmatory (Phase III). Countries: Germany (ongoing, recruiting), Croatia (ongoing, recruiting), Poland (authorised, recruiting), Sweden (authorised, recruiting), Portugal (ongoing, recruiting), Netherlands (authorised, recruiting), Italy (ongoing, recruiting), Denmark (authorised, recruiting), Slovakia (ongoing, recruiting), Spain (ongoing, recruiting), Norway (ongoing, recruiting), Romania (ongoing, recruiting), Belgium (authorised, recruiting), Greece (ongoing, recruiting), France (ongoing, recruiting).
Therapeutic area(s): Diseases [C] - Female Urogenital Diseases and Pregnancy Complications [C13]; Diseases [C] - Male Urogenital Diseases [C12]
Gender: Female, Male. Age: 0-17 years, 18-64 years, 65+ years. Enrolment: 105.
Start date (EU): 2026-04-02. Decision date: 2026-03-17. Results received: No. Last updated: 2026-04-09.
Decision dates by country: BE: 2026-03-17, HR: 2026-03-24, DK: 2026-03-23, DE: 2026-03-17, GR: 2026-03-19, IT: 2026-03-19, PT: 2026-03-19, RO: 2026-03-30, ES: 2026-03-26, SE: 2026-03-17, NL: 2026-03-27, NO: 2026-03-18, PL: 2026-03-27, SK: 2026-03-25, FR: 2026-04-09

Condition(s): Focal segmental glomerulosclerosis
Product: BI 764198, Placebo matching BI 764198

Primary endpoint: Relative change in 24-hour urinary protein-to-creatinine ratio (UPCR, measured in mg/g) from baseline to Week 104
Endpoint(s): Key secondary endpoint: Absolute change in eGFRcys in mL/min/1.73m2 from baseline to Week 104, Key secondary endpoint: Treatment response, defined as 24-hr UPCR <1000 mg/g at Week 104, Treatment response, defined as 24-hr UPCR <1000 mg/g and eGFRcys ≥85% vs. baseline at Week 104 and no treatment failure between randomisation and Week 104 (combined or multi-component endpoint), Complete remission, defined as 24-hr UPCR <300 mg/g at Week 104, Change from baseline across disease-specific COA NS-SIM-PRO at Week 104, Change from baseline across Clinical Outcome Assessment (COA) KDQOL-36 at Week 104

Source: https://euclinicaltrials.eu/ctis-public/view/2025-522191-86-00